EU clinical trial 2023-509704-14-00: A Randomised, Double-blind, Placebo-controlled, Multi-centre Phase 2b Study to Evaluate the Efficacy, Safety and Tolerability of AZD2693 in Participants with Non-cirrhotic Non-alcoholic Steatohepatitis (NASH) with Fibrosis Who Are Carriers of the PNPLA3 rs738409 148M Risk Allele.
Protocol code: D7830C00004
Sponsor: AstraZeneca AB (Pharmaceutical company). Phase: Therapeutic exploratory (Phase II). Countries: Italy (ended), Spain (ended), Germany (ended).
Therapeutic area(s): Diseases [C] - Nutritional and Metabolic Diseases [C18]
Gender: Female, Male. Age: 18-64 years, 65+ years. Enrolment: 11.
Status: Ended. Start date (EU): 2023-04-28. End date (EU): 2025-09-10. End date: 2025-09-29. Decision date: 2024-07-02. Results received: No. Last updated: 2025-04-23.
Decision dates by country: DE: 2024-07-05, IT: 2024-07-08, ES: 2024-07-02

Condition(s): Non-cirrhotic non-alcoholic steatohepatitis with fibrosis
Product: Placebo for AZD2693 Solution for Injection, Placebo for AZD2693 Solution for Injection

Primary endpoint: - The resolution of NASH without any worsening of liver fibrosis (yes/no) after 52 weeks of treatment., - The resolution of NASH is defined as a ballooning score of 0, inflammation score of 0 to 1 and steatosis score of any degree (from 0 to 3), as assessed by NASH CRN/NAS score., - Worsening of fibrosis is defined as an increase in the NASH CRN fibrosis score.
Endpoint(s): - At least one stage of liver fibrosis improvement with no worsening of NASH(yes/no) after 52 weeks (worsening defined as an increase of at least one stage of either lobular inflammation or hepatocyte ballooning according to NASH CRN criteria), - Improvement in fibrosis by at least one stage based on biopsy after Week 52, - ≥ 2-point improvement in NAS after 52 weeks

Source: https://euclinicaltrials.eu/ctis-public/view/2023-509704-14-00